EU clinical trial 2024-512102-25-00: J1O-MC-JZHD: A Phase 1 Study of Aurora Kinase A Inhibitor LY3295668 Erbumine as a Single Agent and in Combination in Patients With Relapsed/Refractory Neuroblastoma
Protocol code: JIO-MC-JZHD
Sponsor: Eli Lilly & Co. (Pharmaceutical company). Phase: Human Pharmacology (Phase I)- Other. Countries: Spain (ongoing, recruitment ended).
Therapeutic area(s): Diseases [C] - Neoplasms [C04]
Gender: Female, Male. Age: 0-17 years, 18-64 years. Enrolment: 1.
Status: Ongoing, recruitment ended. Start date (EU): 2020-07-29. Decision date: 2024-08-13. Results received: No. Last updated: 2024-10-02.

Condition(s): Neuroblastoma

Primary endpoint: dose-limiting toxicity, safety, including, but not limited to TEAEs (treatment-emergent adverse events), SAEs (serious adverse events), deaths, and clinical laboratory, abnormalities per CTCAE (Common Terminology Criteria for Adverse Events) (Version 5.0), overall response rate, overall Survival

Source: https://euclinicaltrials.eu/ctis-public/view/2024-512102-25-00